EU clinical trial 2024-511707-42-00: Long-term Follow-up of Patients with Spinal Muscular Atrophy Treated with OAV101 IT or OAV101 IV in Clinical Trials
Protocol code: COAV101A12308
Sponsor: Novartis Pharma AG (Pharmaceutical company). Phase: Therapeutic confirmatory (Phase III). Countries: Netherlands (ongoing, recruitment ended), Belgium (ongoing, recruitment ended), France (ongoing, recruitment ended), Denmark (ongoing, recruitment ended), Spain (ongoing, recruitment ended), Italy (ongoing, recruitment ended).
Therapeutic area(s): Diseases [C] - Congenital, Hereditary, and Neonatal Diseases and Abnormalities [C16]
Gender: Female, Male. Age: 0-17 years, 18-64 years. Enrolment: 26.
Status: Ongoing, recruitment ended. Start date (EU): 2023-01-05. Decision date: 2024-08-08. Results received: No. Last updated: 2026-04-02.
Decision dates by country: FR: 2024-08-20, IT: 2024-09-17, DK: 2024-08-13, ES: 2024-08-26, NL: 2024-08-12, BE: 2024-08-08

Condition(s): Spinal Muscular Atrophy
Product: OAV101B, Zolgensma 2 × 10^13 vector genomes/mL solution for infusion

Primary endpoint: Number and proportion of patients reporting treatment-emergent serious adverse events (SAEs) by Medical Dictionary for Regulatory Activities (MedDRA) System Organ Class (SOC) and Preferred Term (PT) for the entire duration of the study (i.e., up to 5 years), Number and proportion of patients reporting treatment-emergent adverse events of special interest (AESIs) by AESI category and MedDRA SOC and PT within each AESI category for the entire duration of the study (i.e., up to 5 years)
Endpoint(s): The number and proportion of participants demonstrating each developmental milestone according to the Developmental Milestone Checklist, The number and proportion of participants demonstrating maintenance of each developmental milestone, Change from Baseline in the Hammersmith Functional Motor Scale – Expanded (HFMSE) total score, Change from Baseline in the Revised Upper Limb Module (RULM) total score, Number and proportion of patients with potentially clinically significant vital sign findings, summarized individually for each vital sign parameter, Number and proportion of patients with potentially clinically significant laboratory values, summarized individually for each laboratory parameter

Source: https://euclinicaltrials.eu/ctis-public/view/2024-511707-42-00